EU clinical trial 2024-512497-10-00: A Phase 3, Randomized, Multicenter, Double-Blind Trial to Evaluate the Efficacy, Safety, and Tolerability of Zasocitinib (TAK-279) Compared to Deucravacitinib in Participants With Moderate-to-Severe Plaque Psoriasis
Protocol code: TAK-279-PsO-3004
Sponsor: Takeda Development Center Americas Inc. (Pharmaceutical company). Phase: Therapeutic confirmatory (Phase III). Countries: Czechia (ended), France (ended), Bulgaria (ended), Latvia (ended), Poland (ended).
Therapeutic area(s): Diseases [C] - Skin and Connective Tissue Diseases [C17]
Gender: Female, Male. Age: 18-64 years, 65+ years. Enrolment: 371.
Status: Ended. Start date (EU): 2025-09-16. End date (EU): 2026-04-22. Decision date: 2025-08-19. Results received: No. Last updated: 2026-03-10.
Decision dates by country: FR: 2025-08-19, PL: 2025-08-22, CZ: 2025-08-20, BG: 2025-10-22, LV: 2025-08-19

Condition(s): Moderate to Severe Plaque Psoriasis
Product: SOTYKTU 6 mg film-coated tablets, Matching Placebo for Deucravacitinib, SOTYKTU 6 mg film-coated tablets, SOTYKTU 6 mg film-coated tablets, ZASOCITINIB, SOTYKTU 6 mg film-coated tablets, Matching Placebo for TAK-279

Primary endpoint: 100% improvement from baseline in Psoriasis Area and Severity Index (PASI-100) response: Proportion of participants achieving PASI-100 at Week 16.
Endpoint(s): 1. PASI-90 response: Proportion of participants achieving PASI-90 at Week 16., 2. Absolute PASI ≤2 response: Proportion of participants achieving PASI ≤2 at Week 16., 3. Enhanced static Physician’s Global Assessment (sPGA) response: Proportion of participants achieving an sPGA of clear (0) at Week 16., 4. PASI-100, PASI-90, sPGA 0, and absolute PASI ≤2 response at Weeks 4, 8, and 12., 5. PASI-75 and sPGA 0/1 at Weeks 4, 8, 12, and 16., 6. Change from baseline and percent change from baseline in PASI score at Weeks 4, 8, 12, and 16., 7. Incidence of treatment-emergent adverse events (TEAEs), 8. Incidence of serious adverse events (SAEs)., 9. Incidence of adverse events of special interest (AESIs)., 10. Changes in vital signs, clinical laboratory parameters, and electrocardiogram (ECG).

Source: https://euclinicaltrials.eu/ctis-public/view/2024-512497-10-00